EU clinical trial 2025-523139-21-00: PHASE I/IIa CLINICAL TRIAL FOR THE TREATMENT OF GRAFT VERSUS HOST DISEASE WITH A NEW GENERATION OF MESENCHYMAL STROMAL CELLS ECTOPICALLY EXPRESSING CXCR4 AND IL-10 IN STEROID-REFRACTORY AND INTOLERANT OR RUXOLITINIB-REFRACTORY PATIENTS
Protocol code: 2G-MSC-GVHD
Sponsor: Fundacion Instituto De Investigacion Sanitaria De Navarra (Laboratory/Research/Testing facility). Phase: Phase I and Phase II (Integrated)- Other. Countries: Spain (not authorised).
Therapeutic area(s): Diseases [C] - Immune System Diseases [C20]
Gender: Female, Male. Age: 18-64 years. Enrolment: 15.
Status: Not authorised. Decision date: 2026-04-09. Results received: No. Last updated: 2026-04-09.

Condition(s): Patients who have developed acute GVHD refractory to corticosteroids and ruxolitinib or that are not eligible to receive ruxolitinib
Product: Allogeneic Adipose Tissue Derived Mesenchymal Stromal Cells (MSC) ectopically expressing CXCR4 and IL10

Primary endpoint: Safety: • Serious Adverse Reactions after sequential infusions of the study drug, regardless of the number of doses the patient has received and during the entire follow-up period. • Serious Unexpected Serious Adverse Reactions at the time of infusion or during follow-up
Endpoint(s): Efficacy The response will be analyzed through clinical and biological parameters

Source: https://euclinicaltrials.eu/ctis-public/view/2025-523139-21-00